EU clinical trial 2022-501464-18-00: A phase IIa, open label, Single-centre study to assess the initial antifibrotic efficacy, safety, tolerability, pharmacokinetic and pharmacodynamic profile of MBF-118 in Crohn’s disease patients with stenosis.
Protocol code: MBF-118CT-02
Sponsor: Medibiofarma S.L. (Pharmaceutical company). Phase: Therapeutic exploratory (Phase II). Countries: Spain (ended).
Therapeutic area(s): Diseases [C] - Digestive System Diseases [C06]
Gender: Female, Male. Age: 18-64 years, 65+ years. Enrolment: 10.
Status: Ended. Start date (EU): 2023-03-01. End date (EU): 2024-09-10. Decision date: 2022-11-24. Results received: Yes. Last updated: 2024-03-27.

Condition(s): Crohn’s disease

Primary endpoint: The primary endpoint of the study is safety and tolerability of MBF-118 administration for 28 days from baseline to end of the follow-up period at Day 56. Number and severity of AEs reported including Clinically Significant Changes in vital signs, physical examination, Laboratory Measurements, and ECGs.
Endpoint(s): Efficacy endpoints • Change from baseline (Day -1) of bowel wall thickness and color Doppler effect of stenosis at Day 28 and Day 56. • Change from baseline (Day -1) of fecal calprotectin at Day 28 and Day 56. • Change from baseline (Day 1) of plasma C-reactive protein at Day 28 and Day 56., Pharmacokinetics endpoints • Plasma: Cmax, Tmax, Area under curve (AUC) and Cmin in plasma at Day 1 and Day 28, and concentration on Day 56. • Feces: concentration of MBF-118 on Day 28 and Day 56, • GI tissue: Concentration of MBF-118 on Day 29.

Source: https://euclinicaltrials.eu/ctis-public/view/2022-501464-18-00